EU clinical trial 2025-524614-28-00: Pharmacokinetics of Aztreonam-Avibactam in Critically Ill Patients with Sepsis Receiving ECMO Support: A Prospective PK Study
Sponsor: Medical University Of Vienna (Educational Institution). Phase: Human Pharmacology (Phase I)- Other. Countries: Austria (authorised, recruitment pending).
Therapeutic area(s): Diseases [C] - Bacterial Infections and Mycoses [C01]
Gender: Female, Male. Age: 18-64 years, 65+ years. Enrolment: 16.
Status: Authorised, recruitment pending. Decision date: 2026-03-22. Results received: No. Last updated: 2026-03-22.

Condition(s): Sepsis

Source: https://euclinicaltrials.eu/ctis-public/view/2025-524614-28-00